EU clinical trial 2024-511858-44-00: Cell therapy for Inclusion Body Myositis (IBM) by muscle injection of autologous uncultured Adipose-Derived Stromal Vascular Fraction (ADSVF): a phase I trial
Sponsor: Assistance Publique Hopitaux De Paris (Hospital/Clinic/Other health care facility). Phase: Phase I and Phase II (Integrated)- First administration to humans. Countries: France (ongoing, recruiting).
Therapeutic area(s): Diseases [C] - Nervous System Diseases [C10]
Gender: Female, Male. Age: 18-64 years, 65+ years. Enrolment: 38.
Status: Ongoing, recruiting. Start date (EU): 2024-10-24. Decision date: 2024-10-24. Results received: No. Last updated: 2024-10-24.

Condition(s): Inclusion Body Myositis

Source: https://euclinicaltrials.eu/ctis-public/view/2024-511858-44-00